EU clinical trial 2024-519798-20-00: Phase II randomized trial of XELOX plus DoSTARlimab versus XELOX alone as Consolidation Treatment after Standard Chemoradiation in pMMR/MSS or MSI-Low Locally Advanced Rectal Cancer (LARC) Patients – IMMUNOSTAR Trial - GOIRC-02-2024
Protocol code: GOIRC-02-2024
Sponsor: G.O.I.R.C. Gruppo Oncologico Italiano Di Ricerca Clinica (Patient organisation/association). Phase: Therapeutic exploratory (Phase II). Countries: Italy (ongoing, recruiting).
Therapeutic area(s): Diseases [C] - Neoplasms [C04]
Gender: Female, Male. Age: 18-64 years, 65+ years. Enrolment: 270.
Status: Ongoing, recruiting. Start date (EU): 2026-01-15. Decision date: 2025-10-20. Results received: No. Last updated: 2025-12-23.

Condition(s): pMMR/MSS or MSI-Low Locally Advanced Rectal Cancer (LARC)
Product: JEMPERLI 500 mg concentrate for solution for infusion

Primary endpoint: Clinical complete response (cCR) is defined as an absence of residual disease on digital and endoscopic rectal examination, as well as the absence of residual disease on rectal MRI, with no restricted diffusion on T2-weighted imaging (cT0N0M0). cCR will be evaluate according to criteria by MSKCC Regression Scheme. Pathological complete response (pCR) is defined as an absence of viable tumor cells after full pathologic examination of the resected specimen (pT0N0M0).
Endpoint(s): Pathological downstaging is defined as pathological stage after surgery compared with the clinical stage at diagnosis., Organ Preservation Rate is defined as not undergoing Total Mesorectal Excision (TME), either as primary management or for local recurrence, or who did not have a permanent colostomy created, at any time up to 3 years., DFS is defined as the time from randomization to recurrence of a tumor., OS is defined as the time from initiation of study treatment to death from any cause., QoL is measured as pre-defined PRO endpoints in this study are mean changes from baseline in the EORTC-QLQ-CR29 questionnaire administered at baseline, after chemoradiation, after consolidation therapy, before starting adjuvant therapy and at the end of adjuvant therapy., Safety will be evaluated in terms of incidence, nature, frequency and severity of Adverse Events (AEs) and laboratory abnormalities graded by National Cancer Institute (NCI) Common Terminology Criteria for Adverse Events (CTCAE) v.5.0., ctDNA prognostic value will be evaluated at the end of chemo/radiation, at the end of consoldation treatment, after surgery (or restaging in NOM), and after the end of adjuvant dostarlimab therapy (or 6 months in other patients), To evaluate cCR at 24 and 36 months defined as an absence of residual disease on digital and endoscopic rectal examination, as well as the absence of residual disease on rectal MRI, with no restricted diffusion on T2- weighted imaging.

Source: https://euclinicaltrials.eu/ctis-public/view/2024-519798-20-00